EU clinical trial 2024-519555-28-00: EMPEROR: A Multicenter, Randomized, Double-blind, Sham-controlled, Parallel Group, Phase 3 Study Evaluating the Efficacy, Safety, and Tolerability of Zorevunersen (STK-001) in Patients with Dravet Syndrome
Protocol code: STK-001-DS-301
Sponsor: Stoke Therapeutics Inc. (Pharmaceutical company). Phase: Therapeutic confirmatory (Phase III). Countries: Spain (ongoing, recruitment ended), France (ongoing, recruitment ended), Italy (ongoing, recruitment ended), Poland (ended), Sweden (ended), Germany (ongoing, recruitment ended).
Therapeutic area(s): Diseases [C] - Nervous System Diseases [C10]
Gender: Female, Male. Age: 0-17 years. Enrolment: 35.
Start date (EU): 2026-03-18. Decision date: 2025-06-30. Results received: No. Last updated: 2026-07-09.
Decision dates by country: SE: 2025-08-13, PL: 2025-09-08, FR: 2025-07-28, ES: 2025-06-30, DE: 2025-09-08, IT: 2025-09-03

Condition(s): Dravet syndrome
Product: STK-001, STK-001

Primary endpoint: Percent change from baseline in major motor seizure frequency (number per 28 days) in patients receiving zorevunersen as compared with sham from Week 16 to Week 28 (consisting of three 4 week intervals).
Endpoint(s): Percent change from baseline in major motor seizure frequency (number per 28 days) in patients receiving zorevunersen as compared with sham at each visit from Week 16 to Week 52 (consisting of nine 4 week intervals)., Net treatment benefit across multiple Vineland 3 outcomes, assessed as change from baseline, in patients receiving zorevunersen as compared with sham at Week 52., Change from baseline in subdomain scores on the Vineland-3 in patients receiving zorevunersen as compared with sham at Week 52.

Source: https://euclinicaltrials.eu/ctis-public/view/2024-519555-28-00